EU clinical trial 2024-516800-40-00: Cysteamine in association with standard therapy for the treatment of hospitalized patients with COVID-19 pneumonia: phase 2 study on safety of a new antiviral and direct therapy on the host
Sponsor: National Institute For Infectious Diseases Lazzaro Spallanzani (Hospital/Clinic/Other health care facility). Phase: Therapeutic exploratory (Phase II). Countries: Italy (authorised, recruitment pending).
Therapeutic area(s): Diseases [C] - Respiratory Tract Diseases [C08]; Diseases [C] - Virus Diseases [C02]
Gender: Female, Male. Age: 18-64 years, 65+ years. Enrolment: 30.
Status: Authorised, recruitment pending. Decision date: 2024-10-21. Results received: No. Last updated: 2024-10-21.

Condition(s): Infectious diseases of respiratory system (COVID-19)
Product: CYSTAGON 150 mg hard capsules

Primary endpoint: Percentage of patients with treatment-related AEs of grade ≥3 within 28 days and 90 days after the start of therapy, Percentage of patients with AEs (of any grade and those with serious conditions) of any grade and regardless of causality within 28 days and 90 days after the start of therapy
Endpoint(s): Percentage of patients who decide to discontinue therapy before day 10 or discharge, Difference between number of tablets taken and expected number of cysteamine tablets, Pharmacokinetic curve of cysteamine at day 7±1 (blood draws at 0, 1, 2 and 3 hours after drug administration), Cytokines and blood biomarkers at baseline and days 3, 7±1 (or hospital discharge if before day 10), 28±3., Modulation of gene expression induced by cysteamine therapy at day 7±1 compared with baseline, Number of days required for SARS-COV-2 swab negativization., Clinical status expressed by the 11 items of the WHO Clinical Progression Scale at day 7, 10 and 28., Number of days to hospital discharge

Source: https://euclinicaltrials.eu/ctis-public/view/2024-516800-40-00